EU clinical trial 2025-522687-33-00: DIROXIMEL FUMARATE TO REDUCE PERIHAEMATOMAL OEDEMA IN INTRACEREBRAL HAEMORRHAGE: A DOUBLE BLIND RANDOMIZED CLINICAL TRIAL (DARLENE)
Protocol code: 2024_0474
Sponsor: Centre Hospitalier Universitaire De Lille (Hospital/Clinic/Other health care facility). Phase: Therapeutic confirmatory (Phase III). Countries: France (ongoing, recruiting).
Therapeutic area(s): Diseases [C] - Nervous System Diseases [C10]
Gender: Female, Male. Age: 18-64 years, 65+ years. Enrolment: 192.
Status: Ongoing, recruiting. Start date (EU): 2026-05-19. Decision date: 2026-02-26. Results received: No. Last updated: 2026-02-26.

Condition(s): Stroke
Product: Vumerity 231 mg gastro-resistant hard capsules, Vumerity Placebo. Le placebo utilisé aura les mêmes caractéristiques que le traitement à l'étude (Vumerity 231 mg) sur son aspect visuel, son goût et sa forme, sans la molécule active. Il sera fourni par la société Synerlab Development.

Primary endpoint: Absolute volume of PHO assessed at 8 ± 1 days with brain non-contrast CT (NCCT) scan.
Endpoint(s): Functional outcome: global disability assessed by overall distribution of mRS score at 6 months (end of follow-up) (shift analysis), Safety outcome: The rate of severe adverse events (see chapter 10 “Safety Assessment”) occurring between the date of randomization and the end of follow-up (six-month visit).

Source: https://euclinicaltrials.eu/ctis-public/view/2025-522687-33-00